EU clinical trial 2023-503384-41-00: C5691003_A Randomized, Double-blind, Placebo-Controlled, Active-Comparator, Multicenter, Phase 3 Study of Brentuximab Vedotin or Placebo in Combination With Lenalidomide and Rituximab in Subjects with Relapsed or Refractory Diffuse Large B-cell Lymphoma (DLBCL) ECHELON-3
Protocol code: SGN35-031
Sponsor: Seagen Inc. (Pharmaceutical company). Phase: Therapeutic confirmatory (Phase III). Countries: Spain (ended), Belgium (ended), Italy (ended), Denmark (ended), Czechia (ended), France (ongoing, recruitment ended), Poland (ended).
Therapeutic area(s): Phenomena and Processes [G] - Circulatory and Respiratory Physiological Phenomena [G09]; Diseases [C] - Respiratory Tract Diseases [C08]
Gender: Female, Male. Age: 18-64 years, 65+ years. Enrolment: 84.
Start date (EU): 2020-12-22. Decision date: 2023-10-13. Results received: No. Last updated: 2026-03-18.
Decision dates by country: PL: 2023-11-17, ES: 2023-10-16, IT: 2023-10-16, FR: 2023-11-03, BE: 2023-10-17, DK: 2023-10-13, CZ: 2023-10-24

Condition(s): Relapsed or refractory diffuse large B-cell lymphoma (DLBCL)
Product: Placebo BRENTUXIMAB"VEDOTIN", RITUXIMAB, BRENTUXIMAB VEDOTIN, Revlimid 5 mg hard capsules

Primary endpoint: OS (Overall Survival)
Endpoint(s): PFS (progression-free survival) per Lugano 2014 by investigator, CR (complete response) rate per Lugano 2014 by investigator, DOR (duration of response) per Lugano 2014 by investigator, Incidence, severity, and seriousness of adverse events (AEs) per National Cancer Institute Common Terminology Criteria for Adverse Events (NCI CTCAE) version 5.0, OS in CD30-positive participants, ORR (objective response rate) per Lugano 2014 by investigator

Source: https://euclinicaltrials.eu/ctis-public/view/2023-503384-41-00